EU clinical trial 2023-510450-16-00: First-in-human Study to Test Safety and Anti-tumor Activity of a Novel Drug for Patients with Advanced Solid Tumor Harboring Genetic Alterations in MET
Protocol code: CA177-1036
Sponsor: Turning Point Therapeutics Inc. (Pharmaceutical company). Phase: Human Pharmacology (Phase I)- First administration to humans. Countries: France (ongoing, recruitment ended).
Therapeutic area(s): Diseases [C] - Neoplasms [C04]
Gender: Female, Male. Age: 18-64 years, 65+ years. Enrolment: 14.
Status: Ongoing, recruitment ended. Start date (EU): 2020-12-16. Decision date: 2024-07-05. Results received: No. Last updated: 2025-10-21.

Condition(s): Phase 1: Advanced solid tumors harboring genetic alterations in MET

Source: https://euclinicaltrials.eu/ctis-public/view/2023-510450-16-00